EU clinical trial 2024-517883-49-00: The Role of the Amylin Analogue Cagrilintide in Bone Metabolism
Protocol code: NN9388-8175
Sponsor: Novo Nordisk A/S, Steno Diabetes Center Copenhagen (Pharmaceutical company, Hospital/Clinic/Other health care facility). Phase: Human Pharmacology (Phase I)- Other. Countries: Denmark (ongoing, recruiting).
Therapeutic area(s): Diseases [C] - Nutritional and Metabolic Diseases [C18]
Gender: Female. Age: 18-64 years, 65+ years. Enrolment: 144.
Status: Ongoing, recruiting. Start date (EU): 2025-05-28. Decision date: 2025-03-21. Results received: No. Last updated: 2026-07-13.

Condition(s): Female (aged between 50-70 years (both included)) with obesity (BMI ≥ 30.0 kg/m2) of post-menopausal state at screening (defined as minimum 12 months of amenorrhea and high levels of follicular stimulating hormone (FSH) ≥16 UI/L. In cases of uncertainty, confirmation of postmenopausal status requires low levels of anti-Müllerian hormone (AMH) and inhibin B).

Source: https://euclinicaltrials.eu/ctis-public/view/2024-517883-49-00